EU clinical trial 2024-514129-43-00: A Cancer Research UK Phase II open label trial in participants with metastatic pancreatic ductal adenocarcinoma of ginisortamab given intravenously I) with first-line standard of care nab-paclitaxel and gemcitabine, or II) in combination with MEK inhibitor maintenance therapy
Protocol code: CRUKD/24/002
Sponsor: Cancer Research UK (Patient organisation/association). Phase: Therapeutic exploratory (Phase II). Countries: Germany (authorised, recruiting), Spain (ongoing, recruiting), Norway (ongoing, recruiting).
Therapeutic area(s): Diseases [C] - Digestive System Diseases [C06]; Diseases [C] - Neoplasms [C04]
Gender: Female, Male. Age: 18-64 years, 65+ years. Enrolment: 43.
Start date (EU): 2025-01-15. Decision date: 2024-12-02. Results received: No. Last updated: 2026-07-21.
Decision dates by country: ES: 2024-12-02, NO: 2024-12-04, DE: 2024-12-03

Condition(s): Metastatic pancreatic ductal adenocarcinoma
Product: Cotellic 20 mg film-coated tablets, Ginisortamab

Primary endpoint: In Module 1, the frequency and causality of AEs, including relatedness, seriousness and severity (graded according to NCI CTCAE Version 5.0), will be assessed by the Investigator., In Module 1, determining a recommended dose following the review of all available clinically relevant data, including but not limited to toxicity, efficacy and PK data by the Sponsor, CI and PIs., In Module 1, PFS, defined as the time from date of starting ginisortamab plus SoC nab-paclitaxel and gemcitabine to date of disease progression or date of death, whichever occurs first. DCR, defined as best response of CR or PR or SD (SD of ≥16 weeks) according to RECIST Version 1.1., In Module 2, the frequency and causality of AEs, including relatedness, seriousness and severity (graded according to NCI CTCAE Version 5.0), will be assessed by the Investigator., In Module 2, determining a recommended dose following the review of all available clinically relevant data, including but not limited to toxicity, efficacy and PK data by the Sponsor, CI and PIs., In Module 2, PFS 1, defined as the time from date of randomisation to date of disease progression or date of death, whichever occurs first.
Endpoint(s): In Module 1, OS, calculated from date of starting ginisortamab plus SoC nab-paclitaxel and gemcitabine to date of death and ORR, defined as rate of CR plus PR according to RECIST Version 1.1., In Module 1, DoR, defined as the time from date of the first confirmed CR or PR according to RECIST Version 1.1 to date of disease progression and TTNT, defined as the time from date of starting ginisortamab plus SoC nab-paclitaxel and gemcitabine to date of starting next treatment regimen following discontinuation of trial treatment in this trial., In Module 1, PK parameters for ginisortamab when given with SoC nab-paclitaxel and gemcitabine. For the safety run-in these will include the Cmax, AUC, T1/2, Vss, CL and Ctrough. For the expansion only the Cmax and Ctrough will be monitored., In Module 2, PFS 2: defined as the time from date of starting a first-line SoC regimen to date of disease progression or date of death, whichever occurs first., In Module 2, OS, calculated from date of starting a first-line SoC regimen to date of death. ORR, defined as rate of best response of CR or PR according to RECIST Version 1.1. DCR, defined as rate of CR, PR, or SD according to RECIST Version 1.1 at 4, 8 and 12 months after randomisation., In Module 2, DoR 1, defined as the time from date of the first confirmed CR or PR according to RECIST Version 1.1 to the date of disease progression. DoR 2: defined as the time from date of randomisation to the date of disease progression, measured in participants who had CR/PR at randomisation. TTNT, defined as the time from date of randomisation to date of starting next treatment regimen., In Module 2, PK parameters for ginisortamab when given with cobimetinib. For the safety run-in these will include the Cmax, AUC, T1/2, Vss, CL, and Ctrough. For the expansion only the Cmax and Ctrough will be monitored.

Source: https://euclinicaltrials.eu/ctis-public/view/2024-514129-43-00